EU clinical trial 2023-503796-14-00: Randomised, crossover bioavailability clinical trial of oral minoxidil 1 mg, after single and multiple dose administration to healthy volunteers under fasting conditions
Protocol code: P23112a
Sponsor: Industrial Farmaceutica Cantabria S.A. (Pharmaceutical company). Phase: Human Pharmacology (Phase I)- Other. Countries: Spain (ended).
Therapeutic area(s): Diseases [C] - Skin and Connective Tissue Diseases [C17]
Gender: Female. Age: 18-64 years. Enrolment: 14.
Status: Ended. Start date (EU): 2024-02-01. End date (EU): 2024-03-01. Decision date: 2023-10-20. Results received: No. Last updated: 2024-01-26.

Condition(s): Androgenetic alopecia

Source: https://euclinicaltrials.eu/ctis-public/view/2023-503796-14-00